EU clinical trial 2025-524810-28-00: A Pivotal Open-label Phase 3 Clinical Study Evaluating the Efficacy and Safety of QTX-2101 in Combination With All-trans Retinoic Acid in Newly Diagnosed, Low-risk Acute Promyelocytic Leukemia
Protocol code: QTX-2101-301
Sponsor: Quetzal Therapeutics LLC (Pharmaceutical company). Phase: Therapeutic confirmatory (Phase III). Countries: Germany (authorised, recruitment pending), Poland (authorised, recruitment pending), Spain (ongoing, recruiting), Romania (authorised, recruitment pending), Italy (authorised, recruitment pending), France (authorised, recruiting).
Therapeutic area(s): Diseases [C] - Neoplasms [C04]
Gender: Female, Male. Age: 18-64 years, 65+ years. Enrolment: 89.
Start date (EU): 2026-07-02. Decision date: 2026-05-13. Results received: No. Last updated: 2026-07-24.
Decision dates by country: RO: 2026-06-02, PL: 2026-05-29, ES: 2026-05-19, IT: 2026-05-27, DE: 2026-05-19, FR: 2026-05-13

Condition(s): Acute Promyelocytic Leukemia
Product: QTX-2101, Arsenic trioxide Accord 1 mg/ml concentrate for solution for infusion

Primary endpoint: PK parameters, including maximum plasma concentration (Cmax) and area under curve (AUC) for all metabolites of arsenic trioxide, including arsenious acid (AsIII), arsenic acid (ASV), total arsenic, dimethylarsinic acid (DMA), and monomethylarsenic acid (MMA)., Molecular complete remission (mCR) defined as absence of promyelocytic leukemia/ retinoic acid receptor alpha (PML/RARA) in the bone marrow per European Leukemia Net (ELN) 2019 criteria for APL. Negativity of PML/RARA is defined as PML/RARA transcript level below 10-4, confirmed by centralized quantitative reverse transcription-polymerase chain reaction (RTqPCR) testing using an assay with a limit of detection (LOD) of 10-5.
Endpoint(s): Incidence of adverse events (AEs), clinically significant laboratory changes, significant electrocardiogram (ECG) findings, and vital sign changes., Landmark EFS at the time of the primary endpoint analysis, defined as time from randomization to the date of induction treatment failure (failure to achieve complete remission [CR]/morphologic complete remission [CRi] after induction), no achievement of mCR after 3 consolidation courses, relapse after CR/mCR, or death from any cause, whichever comes first., Other parameters of efficacy, including CR/CRi rate, defined as achieving CR/CRi at the end of induction and end of Consolidation Cycle 3 per ELN 2019 criteria for APL and landmark overall survival (OS), defined as duration from randomization to date of death due to any cause, Incidences of AEs, clinically significant laboratory changes, significant ECG, and vital sign changes, Summary statistics of QTX-2101 steady-state AUC and Cmax, determined by population PK analysis., Triplicate ECGs with time-matched PK sampling analysis., Participant-reported outcomes assessing quality of life (eg, EORTC QLQ-C30), treatment convenience and satisfaction (eg, CCSQ), health utility (eg, EQ-5D-5L), and overall treatment burden (eg, number of infusion visits, catheter use, and time in treatment)

Source: https://euclinicaltrials.eu/ctis-public/view/2025-524810-28-00